EU clinical trial 2025-524786-25-00: A phase IV proof-of-concept study to assess the safety and efficacy of Maribavir to inhibit high Virus Epstein-Barr (VEB) replication among young adult kidney transplant recipie
Protocol code: MARIVEB
Sponsor: Fundacio Hospital Universitari Vall D’Hebron Institut De Recerca (Laboratory/Research/Testing facility). Phase: Therapeutic use (Phase IV). Countries: Spain (authorised, recruitment pending).
Therapeutic area(s): Diseases [C] - Virus Diseases [C02]; Phenomena and Processes [G] - Immune system processes [G12]
Gender: Female, Male. Age: 18-64 years, 65+ years. Enrolment: 10.
Status: Authorised, recruitment pending. Decision date: 2026-05-13. Results received: No. Last updated: 2026-05-13.

Condition(s): Transplant patients with high recurrent Epstein-Barr infection
Product: LIVTENCITY 200 mg film-coated tablets.

Primary endpoint: Proportion of patients achieving complete viral clearence after Maribavir therapy
Endpoint(s): Proportion of patients with a complete elimination of viral replication during the first study phase, Proportion of patients needing a further maribavir course for a significant reduction of viral replication., Rates of EBV recurrence after maribavir withdrawal, Impact of maribavir on the EBV-specific T and B-cell immune response after therapy, Impact on different B-cell subset phenotypes in peripheral blood., Kinetics of viral replication over the course of the anti-viral therapy

Source: https://euclinicaltrials.eu/ctis-public/view/2025-524786-25-00